EU clinical trial 2023-510107-22-00: A Phase 3, Randomized, Double-Blind, Placebo-Controlled, Multicenter Study of Ravulizumab in Adult and Adolescent Participants who have Thrombotic Microangiopathy (TMA) after Hematopoietic Stem Cell Transplant (HSCT)
Protocol code: ALXN1210-TMA-313
Sponsor: Alexion Pharmaceuticals Inc. (Pharmaceutical company). Phase: Therapeutic confirmatory (Phase III). Countries: Germany (ended), Poland (ended), France (ended), Spain (ended), Sweden (ended), Belgium (ended), Italy (ended), Netherlands (ended), Greece (ended).
Therapeutic area(s): Diseases [C] - Hemic and Lymphatic Diseases [C15]
Gender: Female, Male. Age: 0-17 years, 18-64 years, 65+ years. Enrolment: 61.
Status: Ended. Start date (EU): 2020-10-27. End date (EU): 2026-03-20. End date: 2026-03-20. Decision date: 2024-03-05. Results received: No. Last updated: 2025-07-09.
Decision dates by country: NL: 2024-03-06, SE: 2024-03-06, ES: 2024-03-05, PL: 2024-03-11, GR: 2024-03-20, FR: 2024-04-19, BE: 2024-03-06, DE: 2024-03-07, IT: 2024-03-11

Condition(s): Hematopoietic stem cell transplant-associated thrombotic microangiopathy
Product: Anti C5 Complement mAb Placebo, Ultomiris 300 mg/30 mL concentrate for solution for infusion

Primary endpoint: Event free survival during the 26-week Treatment Period defined as the time from randomization until the first of the two following events: Death and Clinical worsening
Endpoint(s): Overall survival by Day 100, Week 26, Non-relapse mortality during the 26-week Treatment Period, Number of TMA response criteria met during the 26-week Treatment Period, Hematologic response during the 26-week Treatment Period, Change from baseline in eGFR at Week 26

Source: https://euclinicaltrials.eu/ctis-public/view/2023-510107-22-00